EU clinical trial 2023-508496-37-00: A Phase 2, randomised, open label, multicentre study to evaluate efficacy and safety of an intraperitoneal α-emitting radionuclide therapy (Radspherin®) in patients with peritoneal carcinomatosis from colorectal carcinoma following cytoreductive surgery (CRS) and hyperthermic intraperitoneal chemotherapy (HIPEC)
Protocol code: RAD-18-004
Sponsor: Oncoinvent Solutions AS (Pharmaceutical company). Phase: Therapeutic exploratory (Phase II). Countries: Netherlands (authorised, recruitment pending), Norway (authorised, recruitment pending), Sweden (authorised, recruitment pending).
Therapeutic area(s): Diseases [C] - Neoplasms [C04]
Gender: Female, Male. Age: 18-64 years, 65+ years. Enrolment: 65.
Status: Authorised, recruitment pending. Decision date: 2024-04-11. Results received: No. Last updated: 2026-02-27.
Decision dates by country: NO: 2024-04-12, SE: 2024-04-11, NL: 2024-04-15

Condition(s): Carcinomatosis of peritoneal cavity
Product: Radspherin

Primary endpoint: PFS defined as time from date of randomisation until the date of first progression or death, whichever occurs first. PFS will be assessed using CT/MRI and according to Response Evaluation Criteria in Solid Tumours (RECIST) v1.1.
Endpoint(s): OS defined as time from date of randomisation until the date of death from any cause., PPFS defined as time from date from randomisation until the date of first progression in the peritoneum or death from any cause, whichever occurs first. PPFS will be assessed using CT/MRI and according to RECIST v1.1., Change in biomarkers (CEA, CA19-9 and CA125)., Changes from baseline in patient reported outcome scores using QoL forms European Organization for Research and Treatment of Cancer (EORTC) QLQ-C30 and QLQ- CR29., Incidence, relatedness, severity and seriousness of AEs as characterised using the latest version of National Cancer Institute Common Terminology Criteria version 5.0 for AEs (NCI CTCAE), Changes from baseline in laboratory values (haematology, serum biochemistry and urine analyses), vital signs (heart rate and systolic/diastolic blood pressure), and body weight, Proportion of patients with documented surgical complications according to Clavien-Dindo-Slankamenac classification during the treatment period (Day 1 to 29) and until 1 year after the date of randomisation., Incidence, relatedness, severity and seriousness of AESIs as characterised using the NCI CTCAE version 5.0.

Source: https://euclinicaltrials.eu/ctis-public/view/2023-508496-37-00